EU clinical trial 2024-515622-80-00: A Phase III, Multicenter, Open-Label Study to Evaluate the Efficacy, Safety, Pharmacokinetics, and Pharmacodynamics of Emicizumab Prophylaxis in Patients with Type 3 Von Willebrand Disease
Protocol code: WP45338
Sponsor: F. Hoffmann-La Roche AG (Pharmaceutical company). Phase: Therapeutic confirmatory (Phase III). Countries: Belgium (ongoing, recruiting), Sweden (authorised, recruitment pending), Spain (authorised, recruiting), Germany (ongoing, recruiting), France (ongoing, recruiting), Netherlands (ongoing, recruiting), Poland (ongoing, recruiting), Italy (ongoing, recruiting).
Therapeutic area(s): Diseases [C] - Hemic and Lymphatic Diseases [C15]
Gender: Female, Male. Age: 0-17 years, 18-64 years, 65+ years. Enrolment: 47.
Start date (EU): 2025-06-04. Decision date: 2025-05-05. Results received: No. Last updated: 2026-03-11.
Decision dates by country: ES: 2025-05-07, IT: 2025-05-07, BE: 2025-05-05, PL: 2025-05-12, SE: 2025-05-12, NL: 2025-05-07, DE: 2025-05-06, FR: 2025-05-06

Condition(s): Type 3 Von Willebrand Disease
Product: NovoSeven 8 mg (400 KIU) powder and solvent for solution for injection, Voncento 250 IU FVIII / 600 IU VWF (5 ml solvent) powder and solvent for solution for injection/infusion, ADVATE 1 500 IU/2 ml powder and solvent for solution for injection, Voncento 500 IU FVIII / 1200 IU VWF (5 ml solvent) powder and solvent for solution for injection/infusion, ELOCTA 500 IU Powder and solvent for solution for injection, ELOCTA 750 IU Powder and solvent for solution for injection, ELOCTA 2000 IU Powder and solvent for solution for injection, NovoSeven 1 mg (50 KIU) powder and solvent for solution for injection, VEYVONDI 650 IU powder and solvent for solution for injection., ADVATE 1 500 IU/2 ml powder and solvent for solution for injection, Haemate® P 2400 IE vWF / 1000 IE FVIII Pulver und Lösungsmittel zur Herstellung einer Injektions- oder Infusionslösung, VEYVONDI 1300 IU powder and solvent for solution for injection., Haemate® P 600 IE vWF / 250 IE FVIII Pulver und Lösungsmittel zur Herstellung einer Injektions- oder Infusionslösung., Fanhdi 500 IU powder and solvent for solution for injection., NovoSeven 5 mg (250 KIU) powder and solvent for solution for injection, NovoSeven 2 mg (100 KIU) powder and solvent for solution for injection, FEIBA 50 U/ml powder and solvent for solution for infusion, ADVATE 1 500 IU/2 ml powder and solvent for solution for injection, Willfact 2000 IU Powder and solvent for solution for injection, Voncento 500 IU FVIII /1200 IU VWF (10 ml solvent) powder and solvent for solution for injection/infusion, ADVATE 1 500 IU/2 ml powder and solvent for solution for injection, ELOCTA 1000 IU Powder and solvent for solution for injection, Wilate 500, 500 IU VWF/500 IUFVIII, powder and solvent for solution for injection, ELOCTA 4000 IU powder and solvent for solution for injection, ELOCTA 1500 IU Powder and solvent for solution for injection, Haemate® P 1200 IE vWF / 500 IE FVIII Pulver und Lösungsmittel zur Herstellung einer Injektions- oder Infusionslösung, Wilate 1000, 1000 IU VWF/1000 IUFVIII, powder and solvent for solution for injection, Voncento 1000 IU FVIII / 2400 IU VWF (10 ml solvent) powder and solvent for solution for injection/infusion, ELOCTA 3000 IU Powder and solvent for solution for injection, ELOCTA 250 IU Powder and solvent for solution for injection, Hemlibra 150 mg/mL solution for injection

Primary endpoint: Number of treated bleeds over time
Endpoint(s): Number of all bleeds over time, Number of treated spontaneous bleeds over time, Number of treated joint bleeds over time, Incidence and severity of adverse events, Incidence and severity of thromboembolic events, Incidence and severity of thrombotic microangiopathy events, Incidence and severity of injection-site reactions, Incidence of adverse events leading to drug discontinuation, Incidence of severe hypersensitivity, anaphylaxis, or anaphylactoid reactions, Changes from baseline in physical examination findings, vital signs, and ECG parameters, Incidence of laboratory abnormalities, Trough plasma concentration of emicizumab, Prevalence and incidence of ADAs to emicizumab, Change from baseline in Patient-Reported Outcomes Measurement Information System-29 (PROMIS-29)

Source: https://euclinicaltrials.eu/ctis-public/view/2024-515622-80-00